EU clinical trial 2024-518592-60-00: Ceftobiprole OATP1B interaction study
Protocol code: BPR-CP-101
Sponsor: Basilea Pharmaceutica International AG Allschwil (Pharmaceutical company). Phase: Human Pharmacology (Phase I)- Other. Countries: Netherlands (ended).
Therapeutic area(s): Diseases [C] - Respiratory Tract Diseases [C08]
Gender: Female, Male. Age: 18-64 years, 65+ years. Enrolment: 12.
Status: Ended. Start date (EU): 2025-01-17. End date (EU): 2025-02-25. Decision date: 2024-12-24. Results received: No. Last updated: 2024-12-24.

Condition(s): Community-acquired bacterial pneumonia

Source: https://euclinicaltrials.eu/ctis-public/view/2024-518592-60-00